EU clinical trial 2022-502963-39-00: A Phase 1/2, adaptive, open-label, single ascending dose to multiple ascending dose study to evaluate the safety, tolerability, pharmacokinetics, and pharmacodynamics of mRNA-3745 in participants with glycogen storage disease type 1a (GSD1a), followed by an open-label extension
Protocol code: mRNA-3745-P102
Sponsor: Moderna Therapeutics Inc. (Pharmaceutical company). Phase: Phase I and Phase II (Integrated)- First administration to humans. Countries: Spain (ended), Poland (ended), Netherlands (ended), France (ended).
Therapeutic area(s): Phenomena and Processes [G] - Metabolism [G03]
Gender: Female, Male. Age: 0-17 years, 18-64 years. Enrolment: 24.
Status: Ended. Start date (EU): 2024-06-20. End date (EU): 2025-10-06. Decision date: 2024-05-27. Results received: No. Last updated: 2025-07-30.
Decision dates by country: FR: 2024-05-28, PL: 2024-05-31, NL: 2024-05-27, ES: 2024-05-30

Condition(s): Glycogen storage disease type 1a (GSD1a)
Product: PARACETAMOL, FEXOFENADINE, CETIRIZINE, DEXAMETHASONE, mRNA-3745, DIPHENHYDRAMINE, CARBOHYDRATES, IBUPROFEN, HYDROXYZINE, FAMOTIDINE, Isotonische Kochsalzlösung Fresenius, Infusionslösung, ONDANSETRON

Primary endpoint: • Incidence and severity of TEAEs, SAEs, and TEAEs leading to treatment discontinuation. • Changes in vital signs, ECG results, and laboratory findings (including hematology, serum chemistry, urinalysis, and coagulation parameters).
Endpoint(s): • Absence of hypoglycemiaa for up to 12 hours during fasting challenges. • Change from baseline of area under the AUEC of blood glucose and lactate during fasting challenges. • Change from baseline in time to hypoglycemia during fasting challenges. Change in other PD parameters including Emax and TEmax, during fasting challenges., • PK parameters determined during the SAD portion of the study including, but not limited to Cmax, Tmax, AUC0-t, AUC0-inf, t1/2, CL, and Vz. • Additional PK parameters determined during the MAD portion of the study including, but not limited to Cmax,ss, AUC0-t,ss, Vss, and Rac determined by the ratio of AUC0-t,ss and AUC0-t. • Change from baseline in metabolic biomarkers such as blood levels of uric acid, triglycerides, LDL, and HDL.

Source: https://euclinicaltrials.eu/ctis-public/view/2022-502963-39-00